EU clinical trial 2024-513744-28-00: Rescue Therapy with the Human Anti-CD38 Antibody MOR202 (felzartamab) in Patients with Membranous Nephropathy who Failed Anti-CD20 Target Therapy (MONET study)
Sponsor: Istituto Di Ricerche Farmacologiche Mario Negri (Laboratory/Research/Testing facility). Phase: Therapeutic exploratory (Phase II). Countries: Italy (ended).
Therapeutic area(s): Diseases [C] - Immune System Diseases [C20]
Gender: Female, Male. Age: 18-64 years, 65+ years. Enrolment: 10.
Status: Ended. Start date (EU): 2021-10-22. End date (EU): 2025-02-21. Decision date: 2024-06-24. Results received: Yes. Last updated: 2024-09-25.

Condition(s): Membranous nephropathy
Product: AMINOHIPPURIC ACID, OMNIPAQUE 300 mg I/ml soluzione iniettabile, Felzartamab

Primary endpoint: Reduction in 24-hour urinary protein excretion at 12 months after the first MOR202 administration compared to baseline., Composite endpoint of complete remission (24-hour urinary protein excretion <0.3 g or urinary protein to creatinine ratio < 300 mg/g, with serum albumin > 3.5 g/dL) or partial remission (24-hour urinary protein excretion <3.5 g or urinary protein to creatinine ratio < 3500 mg/g, with at least 50% reduction compared to baseline) of nephrotic syndrome at 12 months from the first infusion.
Endpoint(s): Reduction in 24-hour urinary protein excretion at 6, 9, 12, 18 and 24 months, Composite endpoint of complete or partial remission at 6, 9, 12, 18 and 24 months., Complete remission at 6, 9, 12, 18 and 24 months, Depletion of circulating anti-PLA2R (defined as titers < 2 RU/mL by commercially available kits) or anti-THSD7A (defined as negative IIF test) at 6, 9, 12, 18 and 24 months from treatment in patients with PLA2R-related or THSD7A-related MN., Time to NS relapse (defined as 24-hour proteinuria increase to >3.5 g in subjects with previous complete or partial remission), Time to re-emergence of anti-PLA2R or anti-THSD7A in patients with initial depletion, Changes at 6, 9, 12, 18 and 24 months compared to baseline values in: body weight, serum albumin, anti-PLA2R or anti-THSD7A antibody levels, triglycerides, cholesterol (total, LDL, HDL), Changes at 6, 12, 18 and 24 months compared to baseline values in GFR, RPF, as well as albumin, IgG and sodium fractional clearance and calculated FF, RVR and glomerular resistances, Changes in the frequency of circulating T- and NK-cell subpopulations and in B-cell subsets including plasmablasts and plasma cells, Changes in quality of Life (QoL) assessed by the SF-36 questionnaire, PK profile of MOR202 determined by serum concentrations over time, MOR202 immunogenicity, i.e. frequency of anti-MOR202 antibodies (ADA) detection after therapy, Serious and non-serious adverse events, Frequency, incidence, seriousness, relatedness, and severity of treatment-emergent adverse events (TEAEs), including severe hypersensitivity reactions to MOR202 (acute grade III or IV adverse reactions requiring advanced care, or late reactions including delayed serum sickness syndrome) that, independent of response to treatment, may preclude further exposure to the drug.

Source: https://euclinicaltrials.eu/ctis-public/view/2024-513744-28-00